EU clinical trial 2024-510645-34-00: PANIRINOX : Phase II randomized study comparing FOLFIRINOX + Panitumumab versus mFOLFOX6 + Panitumumab in metastatic colorectal cancer patients selected by RAS and B-RAF status from circulating DNA analysis
Protocol code: UC-0110/1608
Sponsor: Unicancer (Hospital/Clinic/Other health care facility). Phase: Therapeutic exploratory (Phase II). Countries: France (ongoing, recruitment ended).
Therapeutic area(s): Diseases [C] - Neoplasms [C04]
Gender: Female, Male. Age: 18-64 years, 65+ years. Enrolment: 225.
Status: Ongoing, recruitment ended. Start date (EU): 2017-06-28. Decision date: 2024-03-22. Results received: No. Last updated: 2024-03-22.

Condition(s): RAS and B-RAF wild-type metastatic colorectal cancer. RAS and B-RAF mutation will be determined using circulating cell-free DNA (ccfDNA) by IntPlex method
Product: OXALIPLATIN, IRINOTECAN, Vectibix 20 mg/ml concentrate for solution for infusion, FOLINIC ACID, CALCIUM LEVOFOLINATE, FLUOROURACIL

Primary endpoint: Complete response rate where complete response is defined as complete disappearance of metastatic lesions after maximum of 12 cycles of chemotherapy and tumor marker level normalization (CEA). Complete disappearance of metastatic lesions will be assessed according to RECIST criteria version 1.1: Disappearance of all target and non-target lesions on the same method of assessment that at baseline (CT Scan or MRI). Every complete response will have to be confirmed 4 to 6 weeks after the last trt
Endpoint(s): Overall Survival (OS) is defined as the time from the date of randomization to the date of documented death from any cause, Progression-Free Survival (PFS) is defined as the time from the date of randomization to the date of documented progression or any cause of death. Progression will be assessed by CT scan or MRI according to RECIST criteria version 1.1, Secondary resection rate is defined as the percentage of patients with initially irresectable metastases who will have a secondary resection R0 or R1 of their metastases, Early tumor shrinkage (ETS) is defined as the relative change in the sum of longest diameters of RECIST target lesions after 4 cycles compared to baseline, Depth of response (DpR) is defined as the relative change in the sum of longest diameters of RECIST target lesions at the nadir, in the absence of new lesions or progression of non-target lesions, as compared to baseline, Adverse events rate will be graded based on NCI CTCAE v4.03 classification, Diagnostic performance of ccfDNA analysis compared to the tumor-tissue analysis (current gold standard)

Source: https://euclinicaltrials.eu/ctis-public/view/2024-510645-34-00